EU clinical trial 2023-509019-97-00: HEAT-AML (Hydroxyurea-Enhanced Ara-C Treatment of Adult Acute Myeloid Leukaemia): A phase I/II multi-centre study to assess the tolerability and efficacy of the addition of hydroxyurea to standard ara-C and daunorubicin-based therapy for adults (age ≥ 18 years of age) with newly diagnosed acute myeloid leukaemia (AML)
Sponsor: Karolinska University Hospital (Hospital/Clinic/Other health care facility). Phase: Phase I and Phase II (Integrated)- Other. Countries: Sweden (ongoing, recruitment ended).
Therapeutic area(s): Diseases [C] - Hemic and Lymphatic Diseases [C15]
Gender: Female, Male. Age: 18-64 years, 65+ years. Enrolment: 69.
Status: Ongoing, recruitment ended. Start date (EU): 2019-07-15. Decision date: 2024-03-18. Results received: No. Last updated: 2024-03-18.

Condition(s): Newly diagnosed acute myeloid leukaemia (AML) in patients ≥ 18 years of age
Product: Hydroxycarbamide medac 500 mg capsule, hard, Cytarabine STADA 20 mg/ml injektionsvätska, lösning, Cerubidin 20 mg pulver till infusionsvätska, lösning

Primary endpoint: MRD-negativity after cycle 2. Defined as malignant blasts as a percentage of total bonemarrow cells and as a percentage of the whole white blood cell compartment. These percentages are calculated based on the frequency of cells with an aberrant phenotype.
Endpoint(s): Safety and tolerability (frequency and severity of non-hematological toxicities)., Time to hematopoietic recovery (ANC 0.5 and 1.0 x 109/L; platelets 50 x 109/L) after each chemotherapy treatment cycle, defined as the time from the start of the cycle until recovery., Efficacy profile (response rate (CR, CRi, MLFS), event free survival (EFS), relapse-free survival (RFS), and overall survival (OS))

Source: https://euclinicaltrials.eu/ctis-public/view/2023-509019-97-00